EU clinical trial 2025-520840-14-00: Drug-Drug Interaction Study With BIA 28-6156 and Clarithromycin, Midazolam, and Dabigatran Etexilate in Healthy Participants
Protocol code: BIA-28-6156-113
Sponsor: Bial Portela & Ca S.A. (Pharmaceutical company). Phase: Human Pharmacology (Phase I)- Other. Countries: Belgium (ended).
Therapeutic area(s): Diseases [C] - Nervous System Diseases [C10]
Gender: Female, Male. Age: 18-64 years, 65+ years. Enrolment: 32.
Status: Ended. Start date (EU): 2025-04-29. End date (EU): 2025-07-24. Decision date: 2025-04-08. Results received: No. Last updated: 2025-05-08.

Condition(s): Healthy volunteers

Source: https://euclinicaltrials.eu/ctis-public/view/2025-520840-14-00